EU clinical trial 2024-517674-23-00: Evaluating oral peri-operative acetylsalicylic acid in subjects undergoing endovascular coiling-only of unruptured brain aneurysms (EVOLVE)
Protocol code: DR220153
Sponsor: University Of Calgary (Educational Institution). Phase: Therapeutic confirmatory (Phase III). Countries: France (ongoing, recruiting).
Therapeutic area(s): Diseases [C] - Nervous System Diseases [C10]
Gender: Female, Male. Age: 18-64 years, 65+ years. Enrolment: 200.
Status: Ongoing, recruiting. Start date (EU): 2026-04-09. Decision date: 2024-10-30. Results received: No. Last updated: 2026-03-17.

Condition(s): Subjects undergoing elective endovascular coiling-only repair of unruptured brain aneurysms.
Product: LACTOSE MONOHYDRATE, SALOSPIR® 325 mg Δισκία

Primary endpoint: Incidence of embolic strokes (clinically or on DWI-MRI) in ASA vs placebo on Day 5 of the study (12-48 hours following coiling procedure).
Endpoint(s): Clinical thromboembolic events by Day 90 following coiling, Count of new DWI lesions on post-coiling MRI, Frequency of large (> 10 cc volume) strokes on DWI MR, Incidence of cognitive decline from baseline to 90-day follow-up, Incidence of visible thrombus formation during the coiling procedure, Total volume of embolic strokes on DWI MR imaging, Death rate within 90 days following coiling in the ASA vs. placebo group, Any peri-operative hemorrhagic complication (intracranial hemorrhage, retroperitoneal hematoma, upper or lower gastrointestinal bleeding, or any bleeding stratified as major according to TIMI (Thrombolysis in Myocardial Infarction)), To assess whether treatment with ASA is associated with better short- and long-term cognitive and neuropsychiatric outcomes up to 1-year post-procedure, To examine these outcomes in patients with different burdens of iatrogenic brain infarcts, and assess how any treatment effects of ASA are mediated by this infarct burden, To assess whether ASA is associated with better cognitive-related activities of daily living (ADLs) and health-related quality of life up to 1-year post-procedure

Source: https://euclinicaltrials.eu/ctis-public/view/2024-517674-23-00